EU clinical trial 2024-512998-27-00: A Prospective, Open-Label, Randomized, Phase 3 Trial of Acasunlimab (GEN1046) in Combination With Pembrolizumab Versus Docetaxel in Subjects With PD-L1 Positive Metastatic Non-Small Cell Lung Cancer After Treatment With a PD-1/PD-L1 Inhibitor and Platinum-Containing Chemotherapy (ABBIL1TY NSCLC-06)
Protocol code: GCT1046-06
Sponsor: Genmab A/S (Pharmaceutical company). Phase: Therapeutic confirmatory (Phase III). Countries: Poland (ongoing, recruitment ended), Netherlands (ongoing, recruitment ended), Hungary (ended), Bulgaria (ongoing, recruitment ended), Estonia (ended), Ireland (ongoing, recruitment ended), Germany (ongoing, recruitment ended), Belgium (ongoing, recruitment ended), Greece (ongoing, recruitment ended), Spain (ongoing, recruitment ended), Portugal (ended), France (ongoing, recruitment ended), Italy (ongoing, recruitment ended), Austria (ongoing, recruitment ended), Croatia (ended).
Therapeutic area(s): Diseases [C] - Neoplasms [C04]
Gender: Female, Male. Age: 18-64 years, 65+ years. Enrolment: 398.
Start date (EU): 2025-02-21. Decision date: 2025-01-22. Results received: No. Last updated: 2026-07-08.
Decision dates by country: PT: 2025-01-24, HU: 2025-01-24, EE: 2025-01-24, HR: 2025-01-27, AT: 2025-01-27, PL: 2025-01-27, GR: 2025-01-22, NL: 2025-01-22, DE: 2025-01-24, BG: 2025-01-27, ES: 2025-01-22, FR: 2025-01-23, IT: 2025-01-24, BE: 2025-01-22, IE: 2025-01-24

Condition(s): Non-Small Cell Lung Cancer
Product: PREDNISONE, KEYTRUDA 25 mg/mL concentrate for solution for infusion, CellCept 500 mg film-coated tablets, METHYLPREDNISOLONE, RoActemra 20 mg/mL concentrate for solution for infusion, ANAKINRA, Acasunlimab, DOCETAXEL, DEXAMETHASONE

Primary endpoint: Overall survival (OS)
Endpoint(s): Progression-free survival (PFS), Confirmed objective response rate (ORR), Duration of response (DoR), Number of participants with adverse events (AEs), Time to treatment discontinuation due to AE, Plasma concentration of acasunlimab, Number of participants with anti-drug antibodies (ADAs) to acasunlimab, Change from baseline in Functional Assessment of Cancer Therapy item GP5 (FACIT-GP5, version 4) score, Patient-Reported Outcomes version of the Common Terminology Criteria for Adverse Events (PRO-CTCAE)

Source: https://euclinicaltrials.eu/ctis-public/view/2024-512998-27-00